EU clinical trial 2024-516764-29-00: Ketoanalogue Supplementation for Muscle Protection in CKD 4 and 5 Patients with Moderately Low Protein Diet
Protocol code: RBHP 2023 ANIORT 2
Sponsor: CHU Gabriel-Montpied (Hospital/Clinic/Other health care facility). Phase: Therapeutic confirmatory (Phase III). Countries: France (ongoing, recruiting).
Therapeutic area(s): Diseases [C] - Musculoskeletal Diseases [C05]
Gender: Female, Male. Age: 18-64 years, 65+ years. Enrolment: 100.
Status: Ongoing, recruiting. Start date (EU): 2026-01-05. Decision date: 2025-01-13. Results received: No. Last updated: 2025-09-19.

Condition(s): kidney disease
Product: Ketosteril Ketoacid film-coated tablets

Primary endpoint: Muscle mass index measured by DEXA (appendicular lean mass kg/m²) at 12 months. Appendicular muscle mass is the sum of the lean muscle mass of the upper and lower extremities.
Endpoint(s): Weight and BMI at 3, 6, 12 months, Concentration of albumin, prealbumin and CRP at 3, 6, 9 and 12 months, Serum lipids and glycemia at 12 months, Skin fold and mid arm muscle circumference, Grip strength measured by dynamometry at 12 months, Muscle performance evaluated by walking speed test over 4 meters at 12 months, Serum Calcium and phosphate at 3, 6, 9 and 12 months, Parathormone at 3, 6, 9 and 12 months, 25OH Vitamin D2 + D3 at 12 months, Bone mineral density measured by DEXA at 12 months, Use and dosage of phosphate binders, Time to renal replacement therapy start (or transplantation?), Estimated GFR using 2012 CKD EPI creatinine and cystatin C equation at 12 months, Proteinuria at 12 months

Source: https://euclinicaltrials.eu/ctis-public/view/2024-516764-29-00